EU clinical trial 2024-515379-36-00: A Phase I open label followed by a Phase II randomized, controlled study to assess the efficacy and safety of ABTL0812 in combination with FOLFIRINOX for first-line treatment of metastatic pancreatic cancer
Protocol code: ABT-C11-2020
Sponsor: Ability Pharmaceuticals S.A. (Pharmaceutical company). Phase: Phase I and Phase II (Integrated)- Other. Countries: Spain (ongoing, recruitment ended), France (ongoing, recruitment ended).
Therapeutic area(s): Diseases [C] - Neoplasms [C04]
Gender: Female, Male. Age: 18-64 years, 65+ years. Enrolment: 98.
Status: Ongoing, recruitment ended. Start date (EU): 2020-08-04. Decision date: 2024-11-05. Results received: No. Last updated: 2026-07-02.
Decision dates by country: FR: 2024-11-05, ES: 2024-11-05

Condition(s): Metastatic pancreatic ductal adenocarcinoma
Product: FLUOROURACIL, CALCIUM FOLINATE, IRINOTECAN, OXALIPLATIN, ABTL0812, ABTL0812 Placebo

Primary endpoint: Phase I: Recommended Phase II Dose (RP2D) of ABTL0812 in combination with FOLFIRINOX, Phase II: PFS using RECIST v1.1 by central review
Endpoint(s): Phase I: PFS using RECIST v1.1 by investigator analysis, Phase I: Objective response rate (ORR), Phase I: PFS at 6 months, Phase I: Pharmacokinetic analysis of plasma samples, Phase I: Analysis of TRIB3 and CHOP in blood samples. Additional biomarkers might be included, Phase II: PFS using RECIST v1.1 by investigator analysis, Phase II: Objective response rate (ORR), Phase II: PFS at 6 months, Phase II: Time to second objective disease progression (PFS2), Phase II: Time to response (TTR), Phase II: Duration of response (DOR), Phase II: Overall survival (OS), Phase II: OS at 1 year, Phase II: Disease control rate (DCR) at 16 weeks by central review and investigator analysis, Phase II: Time to first subsequent therapy or death (TFST), Phase II: Adverse Events (AE) physical examination, vital signs and laboratory findings according to Common Terminology Criteria for Adverse Events (CTCAE) v5.0, Phase II: Pharmacokinetic analysis of plasma samples after capsules and oral solution, Phase II: Analysis of TRIB3 and CHOP in blood samples. Additional biomarkers might be included, Phase II: Questionnaires QLQ-C30 and QLQ-PAN26 from EORTC, Phase II: Analysis of DNA mutations and gene expression in solid and liquid biopsies (plasma), Phase II: Analysis of carbohydrate antigen (CA 19-9) in blood. Additional biomarkers might be included

Source: https://euclinicaltrials.eu/ctis-public/view/2024-515379-36-00